EU clinical trial 2025-524856-73-00: A study investigating the safety, absorption, and elimination of RO7795068, a new compound that may potentially be used in the treatment of obesity
Protocol code: BP46585
Sponsor: F. Hoffmann-La Roche AG (Pharmaceutical company). Phase: Human Pharmacology (Phase I)- Other. Countries: Netherlands (ended).
Therapeutic area(s): Health Care [N] - Population Characteristics [N01]
Gender: Female, Male. Age: 18-64 years, 65+ years. Enrolment: 26.
Status: Ended. Start date (EU): 2026-03-13. End date (EU): 2026-07-26. Decision date: 2026-03-11. Results received: No. Last updated: 2026-04-28.
Decision dates by country: NL: 2026-04-24

Source: https://euclinicaltrials.eu/ctis-public/view/2025-524856-73-00